EU clinical trial 2025-524440-35-00: Standard dosed abiraterone versus Therapeutic Drug Monitoring guided abiraterone dosing – The Adapt Abi trial
Protocol code: M25ABI
Sponsor: Het Nederlands Kanker Instituut-Antoni van Leeuwenhoek Ziekenhuis Stichting (Hospital/Clinic/Other health care facility). Phase: Therapeutic use (Phase IV). Countries: Netherlands (authorised, recruitment pending).
Therapeutic area(s): Diseases [C] - Neoplasms [C04]; Diseases [C] - Male Urogenital Diseases [C12]
Gender: Male. Age: 18-64 years, 65+ years. Enrolment: 230.
Status: Authorised, recruitment pending. Decision date: 2026-04-07. Results received: No. Last updated: 2026-05-28.
Decision dates by country: NL: 2026-05-28

Condition(s): metastatic castration resistant prostate cancer (mCRPC)
Product: Abirateron Sandoz 500 mg, filmomhulde tabletten

Primary endpoint: Radiographic progression-free survival (PFS)
Endpoint(s): Feasibility and safety of TDM, Physician adherence to TDM advice, Clinical progression, Overall response rates (ORR), Prostate Specific Antigen response rate (PSArr), PSA response at 12 weeks, Maximal PSA response, Time to PSA progression, Time on treatment (ToT), Overall survival (OS), Quality of life (QoL), Cost-effectiveness, Patient adherence, Toxicity (also in relationship to abiraterone concentrations and dose interventions)

Source: https://euclinicaltrials.eu/ctis-public/view/2025-524440-35-00